EU clinical trial 2024-515973-82-00: A Phase 2b, Multicenter, Double-blind, Placebo-controlled Randomized Withdrawal Study to Assess the Efficacy, Safety, and Tolerability of IMVT-1402 in Adult Participants With Active, Difficult-to-Treat, ACPA-Positive Rheumatoid Arthritis
Protocol code: IMVT-1402-2601
Sponsor: Immunovant Sciences GmbH (Pharmaceutical company). Phase: Therapeutic exploratory (Phase II). Countries: Germany (ongoing, recruitment ended), Poland (ongoing, recruitment ended), Spain (ended), Romania (ongoing, recruitment ended), Hungary (ongoing, recruitment ended), Bulgaria (ongoing, recruitment ended), Czechia (ongoing, recruitment ended).
Therapeutic area(s): Diseases [C] - Immune System Diseases [C20]
Gender: Female, Male. Age: 18-64 years, 65+ years. Enrolment: 123.
Start date (EU): 2025-06-23. Decision date: 2025-05-30. Results received: No. Last updated: 2026-07-20.
Decision dates by country: ES: 2025-05-31, BG: 2025-06-02, RO: 2025-06-04, HU: 2025-05-30, CZ: 2025-05-30, DE: 2025-06-02, PL: 2025-06-03

Condition(s): ACPA-Positive Rheumatoid Arthritis
Product: IMVT-1402, Placebo is identical to IMP but with no active substance

Primary endpoint: Proportion of participants who achieve ACR20 response at Week 28.
Endpoint(s): Change in Clinical Disease Activity Index (CDAI) score from Week 16 to Week 28., Change in Simplified Disease Activity Index (SDAI) score from week 16 to Week 28

Source: https://euclinicaltrials.eu/ctis-public/view/2024-515973-82-00